EU clinical trial 2023-503691-25-00: A trial to examine the biological effects of Saruparib (AZD5305) alone, Darolutamide alone, and in combination in patients with newly diagnosed prostate cancer due to have radical prostatectomy.
Protocol code: D9721C00002
Sponsor: AstraZeneca AB (Pharmaceutical company). Phase: Human Pharmacology (Phase I)- Other. Countries: Netherlands (ended), Spain (ended).
Therapeutic area(s): Diseases [C] - Male Urogenital Diseases [C12]
Gender: Male. Age: 18-64 years, 65+ years. Enrolment: 44.
Status: Ended. Start date (EU): 2023-12-11. End date (EU): 2026-06-01. End date: 2026-06-15. Decision date: 2023-10-11. Results received: No. Last updated: 2026-06-03.
Decision dates by country: NL: 2023-10-12, ES: 2023-10-11

Condition(s): Newly diagnosed prostate cancer

Source: https://euclinicaltrials.eu/ctis-public/view/2023-503691-25-00